EU clinical trial 2023-509283-14-00: Clinical trial evaluating the safety, tolerability, and preliminary efficacy of BNT116 alone and in combinations in patients with advanced non-small cell lung cancer
Protocol code: BNT116-01
Sponsor: BioNTech SE (Pharmaceutical company). Phase: Human Pharmacology (Phase I)- First administration to humans. Countries: Spain (ongoing, recruiting), Hungary (ongoing, recruiting), Germany (ongoing, recruiting), Poland (ongoing, recruiting).
Therapeutic area(s): Diseases [C] - Neoplasms [C04]
Gender: Female, Male. Age: 18-64 years, 65+ years. Enrolment: 156.
Status: Ongoing, recruiting. Start date (EU): 2022-04-25. Decision date: 2024-02-01. Results received: No. Last updated: 2026-04-02.
Decision dates by country: DE: 2024-02-02, HU: 2024-02-01, PL: 2024-02-05, ES: 2024-02-05

Condition(s): Advanced non-small cell lung cancer

Source: https://euclinicaltrials.eu/ctis-public/view/2023-509283-14-00